EU clinical trial 2023-508359-38-00: A Study Evaluating Pharmacokinetic similarity between ABP 234 and Keytruda® (pembrolizumab) in Subjects with Early-stage Non-squamous Non-small Cell Lung Cancer as Adjuvant Treatment Following Resection and Platinum-based Chemotherapy
Protocol code: 20230127
Sponsor: Amgen Inc. (Pharmaceutical company). Phase: Therapeutic confirmatory (Phase III). Countries: Spain (ongoing, recruitment ended), Italy (ongoing, recruitment ended), France (ongoing, recruitment ended), Germany (ongoing, recruitment ended), Bulgaria (ended), Poland (ended), Romania (ongoing, recruitment ended).
Therapeutic area(s): Diseases [C] - Respiratory Tract Diseases [C08]
Gender: Female, Male. Age: 18-64 years, 65+ years. Enrolment: 84.
Start date (EU): 2024-06-05. Decision date: 2024-05-31. Results received: No. Last updated: 2026-07-22.
Decision dates by country: PL: 2024-06-10, BG: 2024-06-03, IT: 2024-05-31, DE: 2024-06-05, ES: 2024-06-10, RO: 2024-09-09, FR: 2024-06-03

Condition(s): Early-stage Non-squamous Non-small Cell Lung Cancer

Source: https://euclinicaltrials.eu/ctis-public/view/2023-508359-38-00